EU clinical trial 2024-515898-96-01: Randomized, parallel study of subcutaneous versus intravenous immunoglobulin in treatment-naïve patients with chronic inflammatory demyelinating polyneuropathy
Sponsor: Region Midtjylland (Hospital/Clinic/Other health care facility). Phase: Phase III and phase IV (Integrated). Countries: Denmark (ended).
Therapeutic area(s): Diseases [C] - Nervous System Diseases [C10]
Gender: Female, Male. Age: 18-64 years, 65+ years. Enrolment: 60.
Status: Ended. End date (EU): 2026-04-30. Decision date: 2024-10-15. Results received: No. Last updated: 2024-10-15.

Condition(s): Chronic inflammatory demyelinating polyneuropathy (CIDP)
Product: Hizentra 200 mg/ml solution for subcutaneous injection, Privigen 100 mg/ml solution for infusion

Primary endpoint: Change in Overall Disability Sum score (ODSS) measured by questionnaire from baseline until end of phase I (26 weeks), Change in Overall Disability Sum score (ODSS) measured by questionnaire from start of phase II and until the lovest effective dosage of immunoglobulin has been reached (up til 60 weeks)
Endpoint(s): Change in parameters describing muscle strength and sensory: Grip strength, MRC-score, INCAT Sensory Sum Score (ISSS), Change in parameters describing functional ability: 10-meter-walk test (10-MWT), 6-spot-step test (6-SST), 9-hole-peg test (9-HPT), Change in parameters describing disability, quality of life, pain and treatment satisfaction: QoL (EQ-5D-5L), Fatigue Severity Scale (FSS), Neuropathic Pain Symptom Inventory (NPSI), Rasch built overall disability scale (RODS) and Treatment Satisfaction Questionnaire for Medication (TSQM), Serum samples: Plasma IgG, Hematology: hemoglobin, reticulocyte count, haptoglobin, bilirubin, plasma haemoglobin, leukocyte count, thrombocyte count., Fluctuations in describing parameter in each arm at pre-defined time points according to IVIG infusions (pre versus post IVIG): Week 0, 4 and 20 versus week 2, 14 and 26

Source: https://euclinicaltrials.eu/ctis-public/view/2024-515898-96-01